EU clinical trial 2023-508334-34-00: A trial to learn how much [11C]savolitinib enters the brains of healthy participants
Protocol code: D5084C00016
Sponsor: AstraZeneca AB (Pharmaceutical company). Phase: Human Pharmacology (Phase I)- Other. Countries: Sweden (ended).
Therapeutic area(s): Diseases [C] - Neoplasms [C04]
Gender: Female, Male. Age: 18-64 years, 65+ years. Enrolment: 8.
Status: Ended. Start date (EU): 2024-03-27. End date (EU): 2024-06-24. Decision date: 2024-03-21. Results received: No. Last updated: 2024-03-21.

Condition(s): Healthy Volunteers

Source: https://euclinicaltrials.eu/ctis-public/view/2023-508334-34-00